EU clinical trial 2024-514570-43-00: TiNivo-2: A Phase 3, Randomized, Controlled, Multicenter, Open-label Study to Compare Tivozanib in Combination with Nivolumab to Tivozanib Monotherapy in Subjects with Renal Cell Carcinoma Who Have Progressed Following One or Two Lines of Therapy Where One Line has an Immune Checkpoint Inhibitor
Protocol code: AV-951-20-304
Sponsor: Aveo Pharmaceuticals Inc. (Pharmaceutical company). Phase: Therapeutic confirmatory (Phase III). Countries: Italy (ended), Germany (ended), Poland (ended), France (ended), Spain (ended), Czechia (ended), Portugal (ended), Belgium (ended).
Therapeutic area(s): Diseases [C] - Neoplasms [C04]
Gender: Female, Male. Age: 18-64 years, 65+ years. Enrolment: 169.
Status: Ended. Start date (EU): 2022-01-24. End date (EU): 2025-11-10. End date: 2026-01-20. Decision date: 2024-10-15. Results received: Yes. Last updated: 2025-11-10.
Decision dates by country: PT: 2024-10-15, BE: 2024-10-17, ES: 2024-10-16, PL: 2024-11-11, CZ: 2024-10-17, IT: 2024-10-21, DE: 2024-10-16, FR: 2024-10-18

Condition(s): Renal cell carcinoma
Product: OPDIVO 10 mg/mL concentrate for solution for infusion., TIVOZANIB, TIVOZANIB

Primary endpoint: Progression free survival: Comparison of the PFS of tivozanib in combination with nivolumab to tivozanib in subjects with RCC who have progressed following 1 or 2 lines of therapy. PFS is defined as the time from randomization to first documentation of objective tumor progression (progressive disease [PD], radiological) according to RECIST, or death due to any reasons whichever comes first.
Endpoint(s): Overall Survival: Comparison of the OS of subjects randomized to treatment with tivozanib in combination with nivolumab compared to tivozanib. OS is defined as the time from the date of randomization to date of death due to any cause., Progression free survival: PFS is defined as the time from randomization to first documentation of objective tumor progression (progressive disease [PD], radiological) according to RECIST, or death due to any reasons whichever comes first. PFS as assessed by investigator., Objective Response Rate: Comparison of ORR of subjects randomized to treatment with tivozanib in combination with nivolumab compared to tivozanib. ORR is defined as the proportion of subjects with confirmed complete response or confirmed partial response according to RECIST relative to the total population of randomized subjects., Duration of Response: Comparison of DoR of subjects randomized to treatment with tivozanib in combination with nivolumab compared to tivozanib. DoR is defined as the time from the first documentation of objective tumor response to the first documentation of objective tumor progression or to death due to any cause., Number of subjects with serious and non-serious adverse events: Assessment of the safety and tolerability of tivozanib in combination with nivolumab compared to tivozanib.

Source: https://euclinicaltrials.eu/ctis-public/view/2024-514570-43-00